EU clinical trial 2023-504207-89-00: (20275) An extension study to evaluate the long-term outcomes of subjects who received treatment for retinopathy of prematurity in Study 20090
Protocol code: 20275
Sponsor: Bayer AG (Pharmaceutical company). Phase: Therapeutic confirmatory (Phase III). Countries: Sweden (ended), Italy (ended), Portugal (ended), Bulgaria (ended), Romania (ended), Belgium (ended), Czechia (ended), Spain (ended), Slovakia (ended), Greece (ended).
Therapeutic area(s): Diseases [C] - Eye Diseases [C11]
Gender: Female, Male. Age: 0-17 years. Enrolment: 39.
Status: Ended. Start date (EU): 2020-03-27. End date (EU): 2025-09-19. End date: 2025-09-20. Decision date: 2023-11-13. Results received: Yes. Last updated: 2025-07-16.
Decision dates by country: BE: 2023-11-17, BG: 2023-11-17, CZ: 2023-11-16, GR: 2023-12-15, IT: 2023-11-16, PT: 2023-11-16, RO: 2023-11-15, ES: 2023-11-13, SE: 2023-11-14, SK: 2023-11-13

Condition(s): Retinopathy of prematurity
Product: Eylea 40 mg/mL solution for injection in a vial

Primary endpoint: Binocular best-corrected visual acuity in Snellen equivalent score at 5 years of age.
Endpoint(s): Proportion of subjects with ocular adverse events (AEs) and serious AEs (SAEs) through 5 years of age, Proportion of subjects with systemic AEs and SAEs through 5 years of age, Proportion of subjects developing unfavorable ocular structural outcome (retinal detachment, macular dragging, macular fold, retrolental opacity) at 1, 3, and 5 years of age, Proportion of subjects with absence of active ROP and unfavorable structural outcomes at 1 year of age, Best-corrected visual acuity in each eye at 3 and 5 years of age, Refractive spherical equivalent in each eye at 3 and 5 years of age, Neurodevelopmental outcomes at 2 and 5 years of age using standardized development tests (eg, Bayley Scales of Infant and Toddler Development, Third Edition [BSID-III], the Differential Ability Scales® II [DAS-II®], the Wechsler Preschool and Primary Scale of Intelligence™, Fourth Edition [WPSSI-IV], Vineland Adaptive Behavior Scales, Second Edition [VABS-II])., Proportion of subjects with recurrence of ROP at 3 and 5 years of age, Proportion of subjects requiring treatment for ROP during this extension study, Proportion of subjects requiring ophthalmological treatment during this extension study

Source: https://euclinicaltrials.eu/ctis-public/view/2023-504207-89-00